EU clinical trial 2023-505745-16-00: A study to evaluate the safety, tolerance and changes in blood levels of an anti-toxin drug (FBT-002) in healthy male and female subjects
Sponsor: Eurofins Optimed, Fabentech (Pharmaceutical company). Phase: Human Pharmacology (Phase I)- First administration to humans. Countries: France (ended).
Therapeutic area(s): Not possible to specify
Gender: Female, Male. Age: 18-64 years. Enrolment: 24.
Status: Ended. Start date (EU): 2024-01-05. End date (EU): 2024-09-30. Decision date: 2023-12-20. Results received: No. Last updated: 2024-08-30.

Condition(s): Antidote

Source: https://euclinicaltrials.eu/ctis-public/view/2023-505745-16-00